EU clinical trial 2024-519446-67-00: A prospective randomized open-label phase II clinical study evaluating the efficacy and safety of zoledronic acid addition to standard therapy in patients with glioblastoma
Protocol code: PSKUS-GB01
Sponsor: Pauls Stradins Clinical University Hospital (Hospital/Clinic/Other health care facility). Phase: Therapeutic exploratory (Phase II). Countries: Latvia (authorised, recruiting).
Therapeutic area(s): Diseases [C] - Nervous System Diseases [C10]; Diseases [C] - Neoplasms [C04]
Gender: Female, Male. Age: 18-64 years, 65+ years. Enrolment: 80.
Status: Authorised, recruiting. Start date (EU): 2025-03-06. Decision date: 2025-02-28. Results received: No. Last updated: 2025-02-28.

Condition(s): Glioblastoma
Product: Zometa 4 mg/100 ml solution for infusion

Primary endpoint: Overall Survival (OS): Time from randomization to death from any cause., Progression-Free Survival (PFS): Time from randomization to disease progression (per RANO criteria) or death, whichever occurs first.
Endpoint(s): Objective Response Rate (ORR): Proportion of patients achieving a complete or partial response per RANO criteria., Duration of Response (DOR): Time from the initial response to disease progression or death in patients who respond to treatment., Safety and Tolerability: Incidence of adverse events (AEs), serious adverse events (SAEs), and treatment-related discontinuations, assessed according to NCI CTCAE v5.0 criteria.

Source: https://euclinicaltrials.eu/ctis-public/view/2024-519446-67-00